EU clinical trial 2025-520698-38-00: Phase Ib/II Study Of The Combination Of Cemiplimab Plus Imiquimod and Laser Therapy As Neoadjuvant Treatment In Cutaneous Basal Cell Carcinoma
Protocol code: IOR-REG-2501
Sponsor: Instituto Oncologico Dr. Rosell S.L. (Hospital/Clinic/Other health care facility). Phase: Phase I and Phase II (Integrated)- Other. Countries: Spain (ongoing, recruiting).
Therapeutic area(s): Diseases [C] - Skin and Connective Tissue Diseases [C17]; Diseases [C] - Neoplasms [C04]
Gender: Female, Male. Age: 18-64 years, 65+ years. Enrolment: 18.
Status: Ongoing, recruiting. Start date (EU): 2025-10-22. Decision date: 2025-07-16. Results received: No. Last updated: 2026-07-15.

Condition(s): Cutaneous Basal Cell Carcinoma
Product: IMUNOCARE 5% crema, LIBTAYO 350 mg concentrate for solution for infusion.

Primary endpoint: Phase Ib: ● The primary endpoint is the incidence of adverse events (AE) and treatment-related AEs (TRAEs) assessed by NCI CTCAE v5.0 (Appendix 5)., Phase II: ● The primary endpoint RFS rate at 3 years, defined as the proportion of patients free of locoregional progression or recurrence, distant metastasis (RECIST v 1.1; Appendix 3) or death due to any cause at 3-years from the date of study treatment initiation.
Endpoint(s): Phase Ib: ● Pathological response assessment: proportion of patients with pathologic complete response (pCR) per Immune-Related Pathologic Response Criteria' (irPRC) criteria (Appendix 4): 0% residual viable tumor (RVT) remaining in post-therapy specimen (no signs of cancer) in tissue samples removed during surgery., Objective response rate (ORR), Clinical benefit rate (CBR), Duration of clinical benefit (DBC), Relapse-free survival (RFS), Overall survival (OS), Phase II: ● Pathologic complete response (pCR), Objective response rate (ORR), Clinical benefit rate (CBR), Duration of clinical benefit (DBC), Rate of resectability, downstaging, Overall survival (OS), Adverse events (AE), Treatment-related AEs (TRAEs)

Source: https://euclinicaltrials.eu/ctis-public/view/2025-520698-38-00